EU clinical trial 2024-511009-50-00: The LIFE-MET Study: Lifestyle intervention and Metformin in early puberty. A randomized, placebo-controlled study on the effect of insulin sensitization and/or lifestyle intervention on pubertal progression.
Sponsor: Herlev Hospital (Hospital/Clinic/Other health care facility). Phase: Therapeutic exploratory (Phase II). Countries: Denmark (ongoing, recruiting).
Therapeutic area(s): Diseases [C] - Hormonal diseases [C19]
Gender: Female. Age: 0-17 years. Enrolment: 80.
Status: Ongoing, recruiting. Start date (EU): 2024-08-27. Decision date: 2024-04-30. Results received: No. Last updated: 2025-11-19.

Condition(s): Precocious puberty and overweight
Product: Metformin "Zentiva", filmovertrukne tabletter, Placebo to Metformin Zentiva 1000 mg scored tablet

Primary endpoint: Changes in bone age over 1 year
Endpoint(s): • Breast development • Sex hormones • HOMA-IR (calculated from fasting insulin and glucose) • Metabolic markers • Body composition • Fitness level • Blood pressure and resting heart rate• Daily physical activity energy expenditure • Quality of Life • Age at menarche

Source: https://euclinicaltrials.eu/ctis-public/view/2024-511009-50-00